EU clinical trial 2023-509485-38-00: Phase II study of Atezolizumab plus Tiragolumab in combination with chemoradiotherapy in localized squamous cell carcinoma of the anal canal.
Protocol code: GEMCAD - 2103//MO4
Sponsor: Grupo Espanol Multidisciplinar En Cancer Digestivo (Hospital/Clinic/Other health care facility). Phase: Therapeutic exploratory (Phase II). Countries: Spain (ongoing, recruitment ended).
Therapeutic area(s): Diseases [C] - Neoplasms [C04]
Gender: Female, Male. Age: 18-64 years, 65+ years. Enrolment: 45.
Status: Ongoing, recruitment ended. Start date (EU): 2023-03-29. Decision date: 2024-05-30. Results received: No. Last updated: 2025-04-30.

Condition(s): Squamous cell carcinoma of the anal canal
Product: Tecentriq 1 200 mg concentrate for solution for infusion, Tiragolumab

Primary endpoint: The clinical complete response rate of patients with localized squamous cell carcinoma of the anal canal, defined as the percentage of patients who have achieved complete response, disappearance of all lesions according to RECIST 1.1 and Mandard criteria and no presence of residual disease assessed by biopsy at the end of consolidation phase. For more details, refer to the section 1.14 of the protocol.
Endpoint(s): Secondary efficacy endpoints: Locoregional failure rate (LFR), Secondary efficacy endpoints: Disease-free survival (DFS), Secondary efficacy endpoints: Colostomy-free survival (CFS), Secondary efficacy endpoints: Overall survival (OS), Secondary safety endpoints: Adverse events (AE), Secondary safety endpoints: Treatment-related AEs (TRAEs), Secondary safety endpoints: Patient reported outcomes through the EORTC QLQ-C30 questionnaire

Source: https://euclinicaltrials.eu/ctis-public/view/2023-509485-38-00